EU clinical trial 2026-525518-70-00: Clinical trial to evaluate the correlation between variation in intestinal lactase activity measured with LacTEST 0.45g and alteration of intestinal barrier integrity and/or intestinal permeability in patients with celiac disease
Protocol code: VPH-GXL-2025-04
Sponsor: Venter Pharma S.L. (Pharmaceutical company). Phase: Therapeutic use (Phase IV). Countries: Spain (authorised, recruitment pending).
Therapeutic area(s): Diseases [C] - Digestive System Diseases [C06]
Gender: Female, Male. Age: 18-64 years, 65+ years. Enrolment: 42.
Status: Authorised, recruitment pending. Decision date: 2026-06-11. Results received: No. Last updated: 2026-06-11.

Condition(s): Patients with celiac disease
Product: LacTEST 0,45 g polvo para solución oral.

Primary endpoint: Change in Marsh-Oberhuber classification (see section 6.2.4) after 12 months after starting the GFD treatment, Change in intestinal lactase activity (umol dissacharide/min/g tissue) assessed by direct measurement after 12 months after starting the GFD treatment., Change in Xylose excreted (mg) in urine 5 hours after taking LacTEST 0.45g after 12 months after starting the GFD treatment
Endpoint(s): Change in intestinal lactase activity (umol dissacharide/min/g tissue or U/g) assessed by direct measurement after 12 months after starting the GFD treatment, Change in Xylose excreted (mg) in urine 5 hours after taking LacTEST 0.45g after 6 and 12 months after starting the GFD treatment, Change in antitransglutaminase antibodies (IU/l, mg/dl or g/l) assessed in blood after 6 and 12 months after starting the GFD treatment, Change in intestinal lactase activity (umol dissacharide/min/g tissue or U/g) assessed by direct measurement after 12 months after starting the GFD treatment, Change in Xylose excreted (mg) in urine 5 hours after taking LacTEST 0.45g after 6 and 12 months after starting the GFD treatment, Change in L/M tests (% recovery of L and M, and LMR) after 6 and 12 months after starting the GFD treatment, Change in LBP (µg/ml) after 6 and 12 months after starting the GFD treatment, Change in sCD14 (ng/ml) after 6 and 12 months after starting the GFD treatment, Change in zonulin (ng/l) in stool after 6 and 12 months after starting the GFD treatment, Change in Marsh-Oberhuber classification (see section 6.2.4) after 12 months after starting the GFD treatment, Change in L/M tests (% recovery of L and M, and LMR) after 12 months after starting the GFD treatment, Change in LBP (µg/ml) after 12 months after starting the GFD treatment, Change in sCD14 (ng/ml) after 12 months after starting the GFD treatment, Change in zonulin (ng/l) in stool after 12 months after starting the GFD treatment, Symptoms by determining GIPs (gluten immunogenic peptides) (µg/g) after 6 and 12 months after starting the GFD treatment, Change in Xylose excreted (mg) in urine 5 hours after taking LacTEST 0.45g after 6 and 12 months after starting the GFD treatment, Change in L/M tests (% recovery of L and M, and LMR) after 6 and 12 months after starting the GFD treatment, Change in LBP (µg/ml) after 6 and 12 months after starting the GFD treatment, Change in sCD14 (ng/ml) after 12 months after starting the GFD treatment, Change in zonulin (ng/l) in stool after 6 and 12 months after starting the GFD treatment, Clinical evaluation (score) as a result of several questionnaires at each point: Gastrointestinal Symptom Rating Scale (GSRS), Canadian Celiac Health Survey questionnaire, Celiac Disease Quality of Life (CD-QOL) questionnaire, Celiac Dietary Adherence Test (CDAT)., Results of all the analytical parameters studied at each point, as detailed in the objectives above., Quantity of a T lymphocyte subpopulation γδT cells (% expression of gamma delta TCR receptor) in fresh tissue, both at baseline and 12 months after the start of the DSG., Results of all the analytical parameters studied, as detailed in the objectives above, both at baseline and 12 months after the start of the DSG,, Presence of genotypes C/C, CT or T/T in polymorphism C/T_13910 of MCM6 gene (regulatory region of the LCT gene)., Presence of genotypes G/G, G/A or A/A in polymorphism G/A_22018 of MCM6 gene (regulatory region of the LCT gene)., Results of the rest of the analytical parameters studied, as mentioned in the previous objectives., Exploratory endpoints: Change (pg/ml or fold change) of several inflammatory cytokines assessed in blood, after 6 and 12 months after starting the GFD treatment.

Source: https://euclinicaltrials.eu/ctis-public/view/2026-525518-70-00